EU clinical trial 2025-520748-13-01: Treatment of Chronic Anal Fissure with Ultrasound-Guided Inter-Sphincteric Injections of Botulinum Toxin A
Protocol code: FAC-BOTOX
Sponsor: Hospital Universitario de Burgos (Health care). Phase: Therapeutic use (Phase IV). Countries: Spain (authorised, recruitment pending).
Therapeutic area(s): Diseases [C] - Digestive System Diseases [C06]
Gender: Female, Male. Age: 18-64 years, 65+ years. Enrolment: 50.
Status: Authorised, recruitment pending. Decision date: 2025-01-22. Results received: No. Last updated: 2025-01-22.

Condition(s): Chronic anal fissure
Product: Botulinum Toxin Type A 300 units Powder for solution for injection

Primary endpoint: VAS scale to quantify pain. Wesner scale to assess fecal incontinence It is a 20-point scale FIQL (Fecal Incontinence Quallity of Life) scale of quality of life, in cases of incontinence. Measurement of the thickness of the EAI by endorectal ultrasound

Source: https://euclinicaltrials.eu/ctis-public/view/2025-520748-13-01